EU clinical trial 2024-516849-39-01: BICCS - Beta-lactam Intermittent versus Continuous infusion and Combination antibiotic therapy in Sepsis
Protocol code: APHP180596
Sponsor: Assistance Publique Hopitaux De Paris (Hospital/Clinic/Other health care facility). Phase: Therapeutic confirmatory (Phase III). Countries: France (authorised, recruitment pending).
Therapeutic area(s): Diseases [C] - Bacterial Infections and Mycoses [C01]
Gender: Female, Male. Age: 18-64 years, 65+ years. Enrolment: 600.
Status: Authorised, recruitment pending. Decision date: 2024-11-26. Results received: No. Last updated: 2026-03-19.

Condition(s): antibiotic therapy in Sepsis
Product: CEFTAZIDIME, PIPERACILLIN, CEFTAZIDIME AND BETA-LACTAMASE INHIBITOR, CEFTOLOZANE, CEFTAZIDIME, CEFEPIME, CEFEPIME, MEROPENEM, TAZOBACTAM, TAZOBACTAM, MEROPENEM, AMIKACIN, AMIKACIN, PIPERACILLIN AND BETA-LACTAMASE INHIBITOR, CEFTOLOZANE AND BETA-LACTAMASE INHIBITOR, AVIBACTAM, CEFTAZIDIME

Primary endpoint: The primary endpoint is the mortality rate at day 30 between CID and IID groups.
Endpoint(s): 1. Mortality rate at day 30 in patients with (i) proven GNI, (ii) proven non-fermentative GNI, (iii) proven GNI for which the MIC of the βL used were higher to the accepted break-points 2. Mortality rate at day 30 in patients that received non-carbapenem-βL, 3. Clinical failure defined as meeting any of the following: a) Death either while on trial therapy or within 7 days following completion; b) Receipt of rescue therapy for the trial pathogen within 7 days of completion of trial treatment; c) Removal from the trial due to an adverse event considered related to trial treatment; d) Bacteremia more than 5 days after initiation of trial treatment with the same pathogen (if multiple pathogens at least one with the same AST);, e) Improvement of shock (decrease by more than 50% of the initial norephrine dose or decrease by more at least 2 points of the SOFA score), within 7 days of completion of trial treatment; f) For patients with pneumonia: failure to improve or worsening of oxygenation by the end of trial treatment; g) For patients with intra-abdominal infections and urinary tract infections: need for re-intervention after more than 5 days of effective treatment or need for puncture debridement or sample from th, 4. PK-PD target attainment rate evaluated as a dichotomous variable o For βL (trough or plateau concentration according to randomization group), at day 1, i.e. 24 hours after the loading dose and at day 3, i.e. 72 hours after the loading dose • Target attainment scored “Yes” if measured drug concentration exceeded greater than four times to the causative pathogen MIC as 100% fT > 4*MIC, o For AG, 30 min after the end of the first infusion dose (CMAX) • Target attainment scored “Yes” if measured drug concentration to causative pathogen MIC ratio is greater than 12 as CMAX/MIC > 12, 5. Percentage of patients with superinfection or new nosocomial infection with GNB resistant to the βL administered at inclusion until day 30 6. Percentage of patients with clinical failure for whom at least one of the microorganism responsible for the infection is still recovered in bacterial culture from the initial infected site at end-of-therapy (EOT) or within 7 days after EOT, 7. Percentage of patients with new carriage of MDR-GNB until day 30 (taking into account all clinical samples and rectal surveillance swabs performed routinely each week), i.e one of the following ticarcillin-resistant Pseudomonas aeruginosa, Acinetobacter baumannii, or Stenotrophomonas maltophilia; extended-spectrum β-lactam-producing Entero bacteriaceae; high-concentration cephalosporinase producing AmpC Enterobacteriaceae;, 8. Percentage of patients with new carriage colonization or infection with Pseudomonas aeruginosa not susceptible to the βL administered until day 30 9. Organ failures assessed by AUCSOFA and its organ components measured between day 1 and day 30 10. Percentage of patients with encephalopathy (delay between inclusion and 2 RASS scores = -1 in a row) or renal failure at discharge until day 30 11.Length of ICU and hospital stays until day 30 12.Mortality rate at day 180

Source: https://euclinicaltrials.eu/ctis-public/view/2024-516849-39-01